EU clinical trial 2024-517130-17-00: Phase 1/2 evaluating the addition of venetoclax to standard 3+7 and midostaurin induction treatment in patients with FLT3-mutated Acute Myeloid Leukemia eligible to intensive chemotherapy - MIDOVEN
Protocol code: CHUBX 2024/37
Sponsor: Centre Hospitalier Universitaire De Bordeaux (Hospital/Clinic/Other health care facility). Phase: Phase I and Phase II (Integrated)- Other. Countries: France (authorised, recruitment pending).
Therapeutic area(s): Diseases [C] - Neoplasms [C04]
Gender: Female, Male. Age: 18-64 years, 65+ years. Enrolment: 41.
Status: Authorised, recruitment pending. Decision date: 2026-05-13. Results received: No. Last updated: 2026-05-13.

Condition(s): FLT3-mutated Acute Myeloid Leukemia
Product: Venetoclax, Venetoclax, Venetoclax

Primary endpoint: Proportion of participants with DLTs during the induction phase of VEN in combination with 3+7+MIDO, Proportion of participants with CR/CRi without MRD, after induction chemotherapy with the RP2S, measured by MFC according to ELN2022 (evaluated as soon as possible after hematological recovery or up to D56)
Endpoint(s): Proportion of participants with, and mean number of, DLT, SAE and AE leading to treatment discontinuation, Plasma PK profile and corresponding parameters of VEN, MIDO and MIDO metabolites CPG52421 and CPG62221 include area under the concentration-time curve over a 12-hour dosing interval (AUC0–12h), peak concentration (Cmax), time to reach Cmax (Tmax), trough concentration (Cmin), and steady-state accumulation ratios of AUC0-12h and Cmax. If appropriate AUCtau, AUCinf, T1/2, CL/F, Vz/F will be determined, Proportion of participants with AEs and SAEs during induction, Proportion of participants with AEs and SAEs during consolidation, Proportion of participants with AEs and SAEs during maintenance, Proportion of participants with CR/CRi without MRD, after consolidation 1, consolidation 2, consolidation 3, HSCT, maintenance 3, maintenance 6, maintenance 9 and maintenance 12, measured by MFC according to ELN2022 and with a sensitivity at 10-4 or limit of detection (LOD), Proportion of participants with CR, CRi, CRh, MLFS, PR, no response, non-evaluable for response after induction chemotherapy with the RP2S, according to ELN2022, Proportion of participants with CR/CRi/CRh without MRD, after induction chemotherapy with the RP2S, consolidation 1, consolidation 2, consolidation 3, HSCT, maintenance 3, maintenance 6, maintenance 9 and maintenance 12, measured by MFC according to ELN2022 and with a sensitivity at 10-4 or LOD, Proportion of participants with CR/CRi without MRD, after induction chemotherapy with the RP2S, consolidation 1, consolidation 2, consolidation 3, HSCT, maintenance 3, maintenance 6, maintenance 9 and maintenance 12, measured by RT-qPCR on NPM1 in co-mutated FLT3 and NPM1 subgroup, Proportion of participants with CR/CRi/CRh without MRD, after induction chemotherapy with the RP2S, consolidation 1, consolidation 2, consolidation 3, HSCT, maintenance 3, maintenance 6, maintenance 9 and maintenance 12, measured by RT-qPCR on NPM1 in co-mutated FLT3 and NPM1 subgroup, Proportion of participants with CR/CRi with MRD low-level (MRDLL), after induction chemotherapy with the RP2S, consolidation 1, consolidation 2, consolidation 3, HSCT, maintenance 3, maintenance 6, maintenance 9 and maintenance 12, measured by RT-qPCR on NPM1 in co-mutated FLT3 and NPM1 subgroup, Proportion of participants with CR/CRi/CRh with MRDLL, after induction chemotherapy with the RP2S, consolidation 1, consolidation 2, consolidation 3, HSCT, maintenance 3, maintenance 6, maintenance 9 and maintenance 12, measured by RT-qPCR on NPM1 in co-mutated FLT3 and NPM1 subgroup, Proportion of participants with CR/CRi without MRD, after induction chemotherapy with the RP2S, consolidation 1, consolidation 2, consolidation 3, HSCT, maintenance 3, maintenance 6, maintenance 9 and maintenance 12, measured by NGS on FLT3 in FLT3-ITD subgroup, Proportion of participants with CR/CRi/CRh without MRD, after induction chemotherapy with the RP2S, consolidation 1, consolidation 2, consolidation 3, HSCT, maintenance 3, maintenance 6, maintenance 9 and maintenance 12, measured by NGS on FLT3 in FLT3-ITD subgroup, OS is defined for all patients in a trial; measured from day 1 of inclusion to the date of death from any cause; patients not known to have died at last follow-up are censored on the date they were last known to be alive according to ELN 2022, Event-free survival (EFS) and EFS including MRD relapse (RT-qPCR on NPM1 and/or NGS FLT3-ITD and/or MFC) as event (EFSMRD) are defined according to ELN 2022, Relapse-free survival (RFS), and RFS including MRD relapse (RT-qPCR on NPM1 and/or NGS FLT3-ITD and/or MFC) as event (RFSMRD) are defined according to ELN 2022, Cumulative incidence of relapse (CIR), and CIR including MRD relapse (RT-qPCR on NPM1 and/or NGS FLT3-ITD and/or MFC) as event (CIRMRD) are defined according to ELN 2022, Proportion of participants with HSCT performed in CR/CRi in eligible patients, Proportion of participants with HSCT performed in CR/CRi/CRh in eligible patients, Proportion of participants with HSCT performed in CR/CRi/CRh/MLFS in eligible patients, Plasma PK profile and corresponding parameters of VEN, MIDO and MIDO metabolites CPG52421 and CPG62224 include area under the concentration-time curve over a 12-hour dosing interval (AUC0–12h), peak concentration (Cmax), time to reach Cmax (Tmax), through concentration (Cmin), and steady-state accumulation ratios of AUC0-12h and Cmax. If appropriate AUCtau, AUCinf, T1/2, CL/F, Vz/F will be determined

Source: https://euclinicaltrials.eu/ctis-public/view/2024-517130-17-00